EU clinical trial 2024-519711-33-01: REVEAL Study: Phase 3 Study of the Efficacy and Safety of ION582 in Children and Adults with Angelman Syndrome
Protocol code: ION582-CS2
Sponsor: Ionis Pharmaceuticals Inc. (Pharmaceutical company). Phase: Therapeutic confirmatory (Phase III). Countries: Italy (ongoing, recruiting), Germany (ongoing, recruiting), Poland (ongoing, recruiting), Spain (ongoing, recruiting).
Therapeutic area(s): Diseases [C] - Congenital, Hereditary, and Neonatal Diseases and Abnormalities [C16]
Gender: Female, Male. Age: 0-17 years, 18-64 years. Enrolment: 30.
Status: Ongoing, recruiting. Start date (EU): 2026-04-17. Decision date: 2026-03-09. Results received: No. Last updated: 2026-06-05.
Decision dates by country: ES: 2026-03-13, DE: 2026-03-16, PL: 2026-03-13, IT: 2026-03-09

Condition(s): Angelman syndrome
Product: ION582

Primary endpoint: Change in performance on the Expressive Communication subdomain raw score of the Bayley Scales for Infant and Toddler Development-4 (Bayley-4) without caregiver input in Cohort 1 [Time Frame: Baseline and Week 52]
Endpoint(s): 1. Change in Bayley Scales for Infant and Toddler Development-4 (Bayley-4): Cognition Subdomain Raw Score without caregiver input [Time Frame: Baseline and Week 52], 2. Change in Symptoms of Angelman Syndrome -Clinician Global Impression of Change (SAS-CGI-C): Overall AS [Time Frame: Baseline and Week 52], 3. Change in Vineland Adaptive Behavior Scale-3 (Vineland-3): Receptive Communication Subdomain Raw Score [Time Frame: Baseline and Week 52], 4. Change in Vineland Adaptive Behavior Scale-3 (Vineland-3): Daily Living Skills, Personal Subdomain Raw Score [Time Frame: Baseline and Week 52], 5. Change in Symptoms of Angelman Syndrome - Clinician Global Impression of Change (SAS-CGI-C): Sleep Problems [Time Frame: Baseline and Week 52], 6. Change in Bayley Scales for Infant and Toddler Development-4 (Bayley-4): Fine Motor Subdomain Raw Score without caregiver input [Time Frame: Baseline to Week 52], 7. Change in Observer-Reported Communication Ability (ORCA): Overall Emerging T score [Time Frame: Baseline and Week 52], 8. Percentage of Participants with Treatment-emergent Adverse Events (TEAEs) and Serious Adverse Events (SAEs) [Time Frame: Up to Week 52], 9. Change in Vital Signs and Clinical Laboratory Results [Time Frame: Baseline and Week 52]

Source: https://euclinicaltrials.eu/ctis-public/view/2024-519711-33-01